EU clinical trial 2023-508875-35-00: A randomized, double-blind, placebo-controlled pragmatic study to evaluate FINerenone on clinicAL effIcacy and safeTY in patients with Heart Failure and reduced ejection fraction who are intolerant of or not eligible for treatment with steroidal mineralocorticoid receptor antagonists (FINALITY-HF)
Protocol code: 202304CPC
Sponsor: Colorado Prevention Center (Hospital/Clinic/Other health care facility). Phase: Therapeutic confirmatory (Phase III). Countries: Czechia (authorised, recruitment pending), Hungary (ongoing, recruiting), Poland (ongoing, recruiting), Greece (ongoing, recruiting), Croatia (ongoing, recruiting), Spain (ongoing, recruiting), Italy (ongoing, recruiting).
Therapeutic area(s): Diseases [C] - Cardiovascular Diseases [C14]
Gender: Female, Male. Age: 18-64 years, 65+ years. Enrolment: 816.
Start date (EU): 2025-09-01. Decision date: 2025-06-20. Results received: No. Last updated: 2026-07-06.
Decision dates by country: GR: 2025-06-23, IT: 2025-06-20, HU: 2025-06-25, CZ: 2025-06-24, HR: 2025-06-30, ES: 2025-06-24, PL: 2025-06-30

Condition(s): Heart condition
Product: BAY 94-8862, Finerenone, Finerenone, Placebo for bay 94-8862

Primary endpoint: The primary endpoint is the time to first occurrence of cardiovascular death or a heart failure event.
Endpoint(s): Secondary endpoints include treatment group differences in: Timing and occurrence of total (first and recurrent) events of cardiovascular (CV) death and heart failure (HF) events. Timing and occurrence of total (first and recurrent) HF events. Change in Kansas City Cardiomyopathy Questionnaire – Total Symptom Score (KCCQ-TSS) from baseline to Month 6. Time to CV death. Time to all-cause death.

Source: https://euclinicaltrials.eu/ctis-public/view/2023-508875-35-00